EU clinical trial 2024-518539-13-00: Stabilization of vulnerable atherosclerotic carotid plaques by Rivaroxaban as evaluated by 3D contrast enhanced ultrasound (CEUS)
Sponsor: Rigshospitalet (Hospital/Clinic/Other health care facility). Phase: Phase III and phase IV (Integrated). Countries: Denmark (authorised, recruitment pending).
Therapeutic area(s): Diseases [C] - Cardiovascular Diseases [C14]
Gender: Female, Male. Age: 18-64 years, 65+ years. Enrolment: 62.
Status: Authorised, recruitment pending. Decision date: 2024-10-27. Results received: No. Last updated: 2024-10-27.

Condition(s): Patients with - Stable peripheral artery disease and - Asymptomatic, atherosclerotic plaque/stenosis in the carotid artery; asymptomatic regarding cerebral ischaemia including stroke and transient ischaemic attack (TIA) or amaurosis fugax.
Product: film-coated tablets, Xarelto 2.5 mg film-coated tablets

Primary endpoint: More hyperechoic carotid plaques in the intervention group, with 1 year rivaroxaban treatment, compared to placebo over time determined by increase in plaque echogenicity with at least 20 % in grey-median-scale (GSM) registered by ultrasound, as an expression of plaque stabilizaton by rivaroxaban.
Endpoint(s): volumen, thrombus volumen and intraplaque contrastfilling over time in the intervention-rivaroxaban group compared to placebo. 2) Secondary major events endpoints including but not necessary limited to: - Death (all cause mortality). - MACE (Major Adverse Cardiovascular Events): myocardial infarction, stroke, cardiovascular death. - MALE (Major Adverse Limb Events) e.g. acute og chronic critical limb ischaemia and including amputation above the ankle. - Transient ischaemic attack (TIA) - Major b

Source: https://euclinicaltrials.eu/ctis-public/view/2024-518539-13-00